EU clinical trial 2024-512972-36-00: Phase 1/2a Clinical Trial of BI-1206, a Monoclonal Antibody to CD32b (FcyRIIB), in Combination with Rituximab With or Without Acalabrutinib in Subjects with Indolent B-Cell Non-Hodgkin Lymphoma That Has Relapsed or is Refractory to Rituximab
Protocol code: 17-BI-1206-02
Sponsor: BioInvent International AB (Pharmaceutical company). Phase: Phase I and Phase II (Integrated)- Other. Countries: Spain (ongoing, recruitment ended), Germany (ended).
Therapeutic area(s): Diseases [C] - Neoplasms [C04]
Gender: Female, Male. Age: 18-64 years, 65+ years. Enrolment: 23.
Start date (EU): 2019-05-23. Decision date: 2024-08-12. Results received: No. Last updated: 2026-04-17.
Decision dates by country: DE: 2024-08-20, ES: 2024-08-12

Condition(s): Indolent B-Cell Non-Hodgkin Lymphoma
Product: BI-1206, BI-1206, BI-1206, Calquence 100 mg film-coated tablets

Primary endpoint: • Documenting AEs and SAEs (graded according to National Cancer Institute [NCI] Common Terminology Criteria for Adverse Events CTCAE, and determining causality in relation to BI 1206, rituximab or acalabrutinib.. Causality of AEs/SAEs will be assessed by the Investigator., Phase 1: • Determining the MTD of BI-1206, with no more than 1 of up to 6 subjects at the same dose level experiencing DLT during the 28-day treatment period on induction therapy (i.e., by Day 29/Week 5). If pharmacokinetic (PK) and pharmacodynamic (PD) data suggest an optimal therapeutic dose, the escalation may be halted by the Cohort Review Committee (CRC) prior to reaching the MTD, and the RP2D will be based off the PK, PD, safety tolerability and efficacy data., Phase 2a, BI-1206 in Combination with Rituximab and Acalabrutinib: The recommended dose will be derived from totality of PK, PD, clinical response, safety, and tolerability observed.
Endpoint(s): Evaluation of PK parameters for BI-1206 during the BI-1206 treatment period., Evaluation of ADA response to BI 1206., Measurement of B cell depletion., Assessment of overall response rate (ORR) according to the response criteria for malignant lymphoma (Cheson, 2014). Other endpoints will include time to objective response, duration of response, PFS, and OS., CD32b protein expression levels., Expression levels of CD32b and/or other immunological markers.

Source: https://euclinicaltrials.eu/ctis-public/view/2024-512972-36-00